EU clinical trial 2023-505660-11-00: A Phase III, Randomized, Controlled, Global Multicenter Study to Evaluate the Efficacy and Safety of Oral Tinengotinib versus Physician’s Choice in Subjects with Fibroblast Growth Factor Receptor (FGFR) altered, Chemotherapy- and FGFR Inhibitor-Refractory/Relapsed Cholangiocarcinoma (FIRST-308)
Protocol code: TT420C2308
Sponsor: Transthera Sciences (Nanjing) Inc. (Pharmaceutical company). Phase: Therapeutic confirmatory (Phase III). Countries: Portugal (ongoing, recruiting), Spain (ongoing, recruiting), Italy (ongoing, recruiting), Austria (ongoing, recruiting), Germany (ongoing, recruiting), France (ongoing, recruiting), Poland (ongoing, recruiting), Belgium (ongoing, recruiting).
Therapeutic area(s): Diseases [C] - Neoplasms [C04]
Gender: Female, Male. Age: 18-64 years, 65+ years. Enrolment: 95.
Status: Ongoing, recruiting. Start date (EU): 2024-04-24. Decision date: 2024-02-27. Results received: No. Last updated: 2026-02-05.
Decision dates by country: DE: 2024-02-28, ES: 2024-02-27, FR: 2024-03-01, BE: 2024-05-17, PL: 2024-05-31, PT: 2024-03-01, AT: 2024-03-04, IT: 2024-02-28

Condition(s): Cholangiocarcinoma (LTT, 26.0)
Product: Irinotecan Hikma 20 mg/ml Konzentrat zur Herstellung einer Infusionslösung, Benda-5 FU 50 mg/ml Injektionslösung, Oxaliplatin Hikma 5 mg/ml Konzentrat zur Herstellung einer Infusionslösung, BENDAFOLIN 10 mg/ml Injektionslösung, Oxaliplatin AqVida 5 mg/ml Konzentrat zur Herstellung einer Infusionslösung, Tinengotinib 5 mg, Ribofolin® 10 mg/ml Injektionslösung, 5-Fluorouracil Ebewe 50 mg/ml - Konzentrat zur Herstellung einer Infusionslösung, Irinotecan HCl AqVida 20 mg/ml Konzentrat zur Herstellung einer Infusionslösung, Tinengotinib 4 mg, Tinengotinib 6 mg

Primary endpoint: Part A • Incidence, duration, and severity of adverse events (AEs), as assessed per Common Terminology Criteria for Adverse Events (CTCAE) v5.0 (or the most current version)., Part B • Progression-free survival (PFS) by BICR: PFS is defined as the time from date of randomization to the date of first documented disease progression as assessed by BICR per Response Evaluation Criteria in Solid Tumors (RECIST) v1.116, or date of death due to any cause, whichever is earlier.
Endpoint(s): Part A • ORR，DOR by Investigator, • PK analysis, Part B • Overall survival (OS): OS is defined as the time from date of randomization to date of death of any cause., • Objective Response Rate (ORR) by BICR and by Investigator: ORR is defined as the proportion of subjects with a best overall response of complete response (CR) or partial response (PR), as assessed by BICR and by the investigator, per RECIST v1.1., • Duration of Response (DOR) by BICR and by Investigator: DOR is defined as the time from date of first documented CR or PR to the date of first documented progressive disease (PD) or death due to any cause by BICR and by investigator’s assessment per RECIST v1.1., • PFS by Investigators per RECIST v1.1., • Incidence, duration, and severity of AEs: as assessed per CTCAE v5.0 (or the most current version)., • European Organization for the Research and Treatment of Cancer Quality of Life Questionnaire: global HRQOL, functioning (physical) and symptoms (fatigue); and EORTC QLQ-BIL21 in tinengotinib vs. Physician’s Choice., • Population PK: for the tinengotinib arm.

Source: https://euclinicaltrials.eu/ctis-public/view/2023-505660-11-00